EU clinical trial 2023-507311-35-00: A Study to Evaluate the Pharmacokinetics of Afamelanotide in Patients with Erythropoietic Protoporphyria (EPP).
Protocol code: CUV052
Sponsor: Clinuvel Europe Limited (Pharmaceutical company). Phase: Phase I and Phase II (Integrated)- Other. Countries: Belgium (ended), Netherlands (ended).
Therapeutic area(s): Diseases [C] - Congenital, Hereditary, and Neonatal Diseases and Abnormalities [C16]
Gender: Female, Male. Age: 0-17 years, 18-64 years, 65+ years. Enrolment: 26.
Status: Ended. Start date (EU): 2024-03-07. End date (EU): 2025-01-20. Decision date: 2024-02-20. Results received: Yes. Last updated: 2024-11-04.
Decision dates by country: NL: 2024-04-22, BE: 2024-02-20

Condition(s): Erythropoietic Protoporphyria (EPP)
Product: SCENESSE 16 mg implant

Primary endpoint: Cmax, AUC(0-t)

Source: https://euclinicaltrials.eu/ctis-public/view/2023-507311-35-00